EU clinical trial 2024-513932-11-00: ElderLIDO_1 : Pharmacokinetic study of intravenous lidocaine in young and elderly patients
Protocol code: 35RC23_9774-07
Sponsor: Centre Hospitalier Universitaire De Rennes (Hospital/Clinic/Other health care facility). Phase: Therapeutic use (Phase IV). Countries: France (ongoing, recruitment ended).
Therapeutic area(s): Analytical,Diagnostic,Therapeutic Techniques and Equipment [E]-Surgical Procedures, Operative [E04]
Gender: Female, Male. Age: 18-64 years, 65+ years. Enrolment: 64.
Status: Ongoing, recruitment ended. Start date (EU): 2025-04-28. Decision date: 2025-01-27. Results received: No. Last updated: 2025-11-03.

Condition(s): Anesthesia
Product: LIDOCAINE HYDROCHLORIDE

Primary endpoint: Plasma concentration of lidocaine at steady state
Endpoint(s): Other pharmacokinetic parameters of lidocaine: clearance, area under the curve (AUC), plasma half-life, and volume of distribution., Free concentration of lidocaine., Total morphine-equivalent consumption at 24 hours post-extubation., Maximal pain reported in the post-anesthesia care unit (PACU) and maximal pain at rest and with movement in the 24h post-extubation, assessed using the Numerical Rating Scale (NRS) for pain., Frequency and number of adverse effects attributable to lidocaine at 24 hours post-extubation., Development of a model to estimate the influence of covariates, including age, on the pharmacokinetics of lidocaine.

Source: https://euclinicaltrials.eu/ctis-public/view/2024-513932-11-00